EU clinical trial 2025-523846-29-00: A clinical trial investigating the safety and biological activity of the antibody BNT351 in adults living without and with HIV
Protocol code: BNT351-01
Sponsor: BioNTech SE (Pharmaceutical company). Phase: Human Pharmacology (Phase I)- First administration to humans. Countries: Germany (ongoing, recruiting).
Therapeutic area(s): Diseases [C] - Virus Diseases [C02]
Gender: Female, Male. Age: 18-64 years. Enrolment: 50.
Status: Ongoing, recruiting. Start date (EU): 2026-02-09. Decision date: 2025-12-22. Results received: No. Last updated: 2026-06-05.
Decision dates by country: DE: 2026-01-20

Condition(s): HIV-1 infection

Source: https://euclinicaltrials.eu/ctis-public/view/2025-523846-29-00